EU clinical trial 2024-518304-53-00: A PHASE 3 RANDOMIZED, OPEN-LABEL TRIAL OF SELINEXOR, POMALIDOMIDE, AND DEXAMETHASONE (SPd) VERSUS ELOTUZUMAB, POMALIDOMIDE, AND DEXAMETHASONE (EloPd) IN PATIENTS WITH RELAPSED OR REFRACTORY MULTIPLE MYELOMA (RRMM)
Protocol code: ENM29
Sponsor: European Myeloma Network B.V. (Patient organisation/association). Phase: Therapeutic confirmatory (Phase III). Countries: France (ongoing, recruitment ended), Spain (ongoing, recruitment ended), Netherlands (ongoing, recruitment ended), Greece (ongoing, recruitment ended), Italy (ongoing, recruitment ended), Germany (ongoing, recruitment ended).
Therapeutic area(s): Diseases [C] - Neoplasms [C04]
Gender: Female, Male. Age: 18-64 years, 65+ years. Enrolment: 116.
Status: Ongoing, recruitment ended. Start date (EU): 2022-02-02. Decision date: 2024-10-11. Results received: No. Last updated: 2026-04-23.
Decision dates by country: FR: 2024-10-11, DE: 2024-10-15, ES: 2024-10-14, GR: 2024-11-20, NL: 2024-11-20, IT: 2024-10-21

Condition(s): Relapsed or Refractory Multiple Myeloma (RRMM)
Product: Dexamethason 4 mg JENAPHARM®, Pomalidomide Accord 2 mg hard capsules, Empliciti 400 mg powder for concentrate for solution for infusion., Pomalidomide Accord 3 mg hard capsules, SELINEXOR, Pomalidomide Accord 4 mg hard capsules, Dexa 8 mg inject JENAPHARM Injektionslösung, Pomalidomide Accord 1 mg hard capsules

Primary endpoint: PFS, defined as time from date of randomization until the date of first confirmed progressive disease (PD), per IMWG response criteria, or death due to any cause, whichever occurs first
Endpoint(s): Key secondary efficacy endpoints: • ORR, defined as any response ≥PR • Overall survival (OS) Additional secondary efficacy endpoints: • Clinical benefit rate (CBR), defined as response ≥minimal response (MR) • Duration of response (DOR) • Time to next treatment (TNT) • Time to initial response (TTR) • Time to best response (TTBR) • Time to progression after first post-SPd/EloPd treatment or death (PFS2), Safety and tolerability of study treatment will be evaluated based on AE reports, vital signs, clinical laboratory results, electrocardiogram (ECG) and physical examination findings, by means of the occurrence, nature, and severity of AEs as categorized by the CTCAE v5.0, Patient-reported quality of life (QoL, as measured by the European Organisation for Research and Treatment of Cancer-Quality of Life (EORTC-QLQ-C30), EORTC-QLQ-MY20, and EQ-5D-5L instruments, Selinexor and pomalidomide PK parameters, estimations of maximum plasma concentration, area under the concentration versus time curve (AUC), and apparent clearance, if feasible.

Source: https://euclinicaltrials.eu/ctis-public/view/2024-518304-53-00